EU clinical trial 2025-521446-20-00: First in human, Phase 1a/1b Study of KM-023 in healthy volunteers and Olmsted syndrome patients
Protocol code: KM023-101
Sponsor: Orvida Pharma Ltd. (Pharmaceutical company). Phase: Human Pharmacology (Phase I)- First administration to humans. Countries: France (ongoing, recruiting), Germany (authorised, recruitment pending).
Therapeutic area(s): Diseases [C] - Skin and Connective Tissue Diseases [C17]
Gender: Female, Male. Age: 18-64 years, 65+ years. Enrolment: 66.
Start date (EU): 2025-06-27. Decision date: 2025-06-25. Results received: No. Last updated: 2026-06-22.
Decision dates by country: DE: 2026-06-18, FR: 2025-06-25

Condition(s): Olmsted syndrome

Source: https://euclinicaltrials.eu/ctis-public/view/2025-521446-20-00